EU clinical trial 2024-511533-35-00: Rituximab, bendamustine and cytarabine followed by venetoclax (V-RBAC) in high-risk elderly patients with mantle cell lymphoma (MCL)
Protocol code: FIL_V-RBAC
Sponsor: Fondazione Italiana Linfomi Ets (Patient organisation/association). Phase: Therapeutic exploratory (Phase II). Countries: Italy (ended).
Therapeutic area(s): Diseases [C] - Hemic and Lymphatic Diseases [C15]
Gender: Female, Male. Age: 18-64 years, 65+ years. Enrolment: 130.
Status: Ended. Start date (EU): 2018-09-03. End date (EU): 2025-10-15. Decision date: 2024-09-02. Results received: No. Last updated: 2025-01-31.

Condition(s): Mantle Cell Lymphoma
Product: BENDAMUSTINE, CYTARABINE, VENETOCLAX, RITUXIMAB

Primary endpoint: 2-years progression-free survival (PFS) of the HR patients from date of enrollment
Endpoint(s): The proportion of molecular response (analyzed in the labs of the FIL-MRD Network), The progression-free survival (PFS) of all enrolled patients, and of different subgroups (i.e TP53 mutated patients), The overall survival (OS), The duration of responses (DoR), The proportion of complete remission (CR) before and after venetoclax in the HR group and/or in the LR not responding to R-BAC., The proportion of patients that complete the expected treatment schedule, The safety of venetoclax when administered as consolidation or maintenance after R-BAC

Source: https://euclinicaltrials.eu/ctis-public/view/2024-511533-35-00